EU clinical trial 2024-512996-11-00: NT-NOA - Novel Treatment of some men with Non-Obstructive Azoospermia Et klinisk interventionsforsøg
Sponsor: Region Hovedstaden (Hospital/Clinic/Other health care facility). Phase: Therapeutic exploratory (Phase II). Countries: Denmark (ended).
Therapeutic area(s): Diseases [C] - Male Urogenital Diseases [C12]
Gender: Male. Age: 18-64 years. Enrolment: 16.
Status: Ended. Start date (EU): 2025-04-30. End date (EU): 2026-04-21. Decision date: 2024-06-12. Results received: No. Last updated: 2026-03-30.

Condition(s): Male infertility
Product: Prolia 60 mg solution for injection in pre-filled syringe, Femar, filmovertrukne tabletter

Primary endpoint: Identification of sperm in either semen sample or TESE at day 90 that ideally is compared with prior TESE, if such is available from before study participation
Endpoint(s): Change in proliferation or apoptosis of germ cells assessed by KI-67, PCNA, cleaved parp expression or TUNEL assay on tissue from TESE at day 90 that is subsequently compared with prior TESE if such is available, Number of participants with sperm in the ejaculate (sperm concentration million/mL) assessed by semen sample delivered at day 14 or day 80, Number of pregnancies achieved by sperm from the ejaculate or from TESE, Change in serum levels of reproductive hormones (FSH, LH, AMH, Inhibin B, INSL3) at day 14 and day 80, Change in seminal fluid levels of reproductive hormones (AMH, Inhibin B, INSL3) at day 14 and day 80, Change in serum levels of sex hormones (testosterone, estradiol, SHBG) at day 14 and day 80, Change in the endocrine gonadal function (Inhibin B/FSH ratio, testosterone/LH ratio og AMH/testosterone ratio) at day 14 and day 80

Source: https://euclinicaltrials.eu/ctis-public/view/2024-512996-11-00